EU clinical trial 2023-506016-40-00: Nebulized fentanyl in healthy volunteers: comparison of facial versus intranasal aerosol administration by pharmacometric modeling. Pilot study AEROfen
Protocol code: 2022/0271/HP
Sponsor: CHU De Rouen (Hospital/Clinic/Other health care facility). Phase: Human Pharmacology (Phase I)- Other. Countries: France (ongoing, recruiting).
Therapeutic area(s): Analytical, Diagnostic and Therapeutic Techniques and Equipment [E] - Anesthesia and Analgesia [E03]
Gender: Female, Male. Age: 18-64 years, 65+ years. Enrolment: 20.
Status: Ongoing, recruiting. Start date (EU): 2024-04-19. Decision date: 2023-10-16. Results received: No. Last updated: 2026-07-21.

Condition(s): Healthy Volunteers

Source: https://euclinicaltrials.eu/ctis-public/view/2023-506016-40-00